EU clinical trial 2023-509181-38-00: Metformin treatment of patients with hand osteoarthritis: A randomised, placebo-controlled trial
Sponsor: Bispebjerg Hospital (Hospital/Clinic/Other health care facility). Phase: Therapeutic confirmatory (Phase III). Countries: Denmark (ongoing, recruitment ended).
Therapeutic area(s): Diseases [C] - Musculoskeletal Diseases [C05]
Gender: Female, Male. Age: 18-64 years, 65+ years. Enrolment: 150.
Status: Ongoing, recruitment ended. Start date (EU): 2024-05-03. Decision date: 2024-04-11. Results received: No. Last updated: 2025-06-12.

Condition(s): Osteoarthritis
Product: The placebo is produced by the central pharmacy of the capital region in Denmark. The placebo contains no active ingrediens., Metformin Orifarm 500 mg filmdragerade tabletter

Primary endpoint: Change from baseline in VAS finger joint pain of the target hand after 16 weeks of treatment (at the week 17 visit).

Source: https://euclinicaltrials.eu/ctis-public/view/2023-509181-38-00